EU clinical trial 2022-502503-30-00: Interfant-21: International collaborative treatment protocol for infants under one year with KMT2A-rearranged acute lymphoblastic leukemia or mixed phenotype acute leukemia
Protocol code: SP-MH20INT
Sponsor: Princess Maxima Center For Pediatric Oncology (Hospital/Clinic/Other health care facility). Phase: Therapeutic confirmatory (Phase III). Countries: Netherlands (ongoing, recruiting), Austria (ongoing, recruitment ended), Czechia (ongoing, recruiting), Denmark (ongoing, recruiting), Finland (ongoing, recruiting), Hungary (ongoing, recruiting), Sweden (ongoing, recruiting), Norway (authorised, recruiting), Poland (ended), Portugal (ongoing, recruiting), Italy (ongoing, recruiting), Belgium (ongoing, recruiting), Ireland (ongoing, recruiting), France (ongoing, recruiting), Lithuania (temporarily halted), Germany (ongoing, recruiting), Slovakia (temporarily halted), Spain (ongoing, recruiting), Greece (authorised, recruiting).
Therapeutic area(s): Diseases [C] - Neoplasms [C04]
Gender: Female, Male. Age: 0-17 years. Enrolment: 210.
Start date (EU): 2022-12-15. Decision date: 2023-02-07. Results received: No. Last updated: 2026-08-04.
Decision dates by country: PL: 2023-07-14, DK: 2023-07-03, FR: 2024-03-05, PT: 2023-08-01, SE: 2023-07-26, IE: 2024-03-15, BE: 2024-03-08, SK: 2024-06-07, ES: 2024-04-30, HU: 2023-07-10, IT: 2024-03-22, CZ: 2023-07-12, NL: 2023-02-07, LT: 2024-04-25, FI: 2023-07-14, GR: 2024-07-04, AT: 2023-06-26, NO: 2023-07-20, DE: 2024-06-12

Condition(s): Acute lymphoblastic leukemia
Product: Dexamethason Teva 1,5 mg, tabletten, Solu-Cortef Powder for Solution for Injection or Infusion 100 mg, Xaluprine 20 mg/ml oral suspension, Methotrexaat Teva 10 mg, tabletten, Dexamethasone phosphate 4 mg/ml solution for injection, Mitoxantron Sandoz 2 mg/ml, concentraat voor oplossing voor infusie, Methotrexaat Teva 2,5 mg, tabletten, ENDOXAN I.V., poeder voor oplossing voor injectie (lyofilisaat) 500 mg, Dexamethason Teva 0,5 mg, tabletten, Dexamethasone 10mg/5ml Oral Solution, BLINCYTO 38.5 micrograms powder for concentrate and solution for solution for infusion, Thiosix 10 mg, tabletten, Spectrila 10,000 U powder for concentrate for solution for infusion, Cerubidine 20 mg, poeder en oplosmiddel voor oplossing voor injectie, Emthexate PF 100 mg/ml, oplossing voor injectie, Vincristinesulfaat Teva 1 mg/ml, oplossing voor injectie, Prednison Auro 5 mg, tabletten, ENDOXAN I.V., poeder voor oplossing voor injectie (lyofilisaat) 1000 mg, Thiosix 20 mg, tabletten, Toposin, concentraat voor oplossing voor intraveneuze infusie 20 mg/ml, Spectrila 10,000 U powder for concentrate for solution for infusion, Solu-Medrone powder and solvent for solution for injection or concentrate for solution for infusion 1000 mg/vial., Cytarabine Accord 100 mg/ml, oplossing voor injectie of infusie

Primary endpoint: EFS defined as the time from diagnosis to resistance to induction (i.e. no complete remission at the end of induction) , relapse, death from any cause or second malignancy (whichever occurs first), or time to last follow-up (censored) for patients without events.
Endpoint(s): OS is defined as the time from the date of diagnosis to death from any cause. Patients who are alive will be censored at the date of last follow up. OS will be estimated for the entire study cohort and according to risk group., The endpoints for analysis by risk group will be EFS, cumulative incidence (or percentage) of resistance to induction (no complete remission at the end of induction) , cumulative incidence of relapse (CIR), death in complete remission (CR) and second malignancy., Outcome for the entire study cohort and according to risk group will be evaluated in terms of the protocol specific definition of EFS follows: the time from diagnosis to, resistance to proto-col, relapse, death from any cause or second malignancy (whichever occurs first), or time to last follow-up for patients without events. Cumulative incidence (or percentage) of resistance, CIR, death in CR and second malignancy will also be estimated., MRD response as defined in the protocol and frequencies of MRD levels., Proportion of CD19 negative relapses in the entire study cohort and according to risk group., Proportion of myeloid lineage switches in the entire study cohort and according to risk group., Proportion of grade ≥3 adverse event (AEs) during the blinatumomab course(s). Proportion of adverse events of special interest (AESIs) and serious adverse events (SAEs) in all protocol phases., Proportion of grade ≥2 cardiac disorders (See AESI Table in protocol) at 2 and 5 years after diagnosis, OS after first relapse, defined as the time from first relapse to death from any cause, in the entire study cohort and according to risk group.

Source: https://euclinicaltrials.eu/ctis-public/view/2022-502503-30-00